EU clinical trial 2023-506714-43-00: A multicenter single-arm phase II interventional study to evaluate the activity and safety of the combination of Platinum-Pemetrexed based chemotherapy plus Lorlatinib in ALK positive Non-Small Cell Lung Cancer (NSCLC) with exclusively extracranial disease progression on Lorlatinib
Sponsor: Centro Di Riferimento Oncologico Di Aviano (Hospital/Clinic/Other health care facility). Phase: Therapeutic exploratory (Phase II). Countries: Italy (ongoing, recruiting).
Therapeutic area(s): Diseases [C] - Neoplasms [C04]
Gender: Female, Male. Age: 18-64 years, 65+ years. Enrolment: 45.
Status: Ongoing, recruiting. Start date (EU): 2024-03-15. Decision date: 2024-02-26. Results received: No. Last updated: 2026-04-07.

Condition(s): ALK positive Non-Small Cell Lung Cancer
Product: Pemetrexed Ever Pharma 25 mg/ml concentrato per soluzione per infusione, Carboplatino Hikma 10 mg/ml soluzione per infusione, Cisplatino Accord Healthcare Italia 1 mg/ml concentrato per soluzione per infusione, Lorviqua 100 mg film-coated tablets, Lorviqua 25 mg film-coated tablets

Primary endpoint: PFS defined as the time from randomization to the first documented disease progression or death due to any cause, whichever occurs first
Endpoint(s): intracranial PFS defined as time from randomization until CNS disease progression or death from any cause, OS is defined as the time from randomization until death from any cause, Frequency and severity of adverse events graded according to the NCI Common Terminology Criteria for Adverse Events (CTCAE) version 5.0, Patient reported NSCLC specific QoL as measured by the European Organisation for Research and Treatment of Cancer (EORTC) Quality of Life Questionnaire: - Core 30 (QLQ-C30): Questionnaire consisting of 30 measuring subjects’ general cancer symptoms and functioning - 13-item Lung Cancer (QLQ-LC13) module: A complementary questionnaire measuring lung cancer symptoms and side-effects from conventional chemo- and radiotherapy

Source: https://euclinicaltrials.eu/ctis-public/view/2023-506714-43-00